EU clinical trial 2024-515119-23-00: A phase Ib/II trial evaluating the combination of TG4001 and avelumab in patients with HPV-16 positive recurrent or metastatic malignancies
Protocol code: TG4001.12
Sponsor: Transgene (Pharmaceutical company). Phase: Phase I and Phase II (Integrated)- Other. Countries: Spain (ongoing, recruitment ended), France (ongoing, recruitment ended).
Therapeutic area(s): Diseases [C] - Neoplasms [C04]
Gender: Female, Male. Age: 18-64 years, 65+ years. Enrolment: 142.
Status: Ongoing, recruitment ended. Start date (EU): 2017-08-29. Decision date: 2024-07-16. Results received: No. Last updated: 2026-03-26.
Decision dates by country: ES: 2024-07-16, FR: 2024-07-19

Condition(s): Phase Ib and Phase II part 1: HPV-16 positive recurrent or metastatic malignancies including oropharyngeal squamous cell carcinoma of head and neck, cervical cancer, vulvar cancer, vaginal cancer, penile cancer, anal cancer; Phase II part 2: HPV-16 positive recurrent or metastatic malignancies including cervical cancer, vulvar cancer, vaginal cancer, penile cancer, anal cancer
Product: TG4001, Bavencio 20 mg/mL concentrate for solution for infusion

Primary endpoint: Phase Ib: safety and tolerability, Phase II part 1: overall response rate according to RECIST 1.1, Phase II part 2: progression-free survival according to RECIST 1.1
Endpoint(s): Phase Ib: Overall response rate by using RECIST 1.1 and overall safety profile, Phase Ib and phase II part 2: Overall response rate by using RECIST 1.1, Phase Ib and phase II part 1: Progression Free Survival (PFS), Overall Survival (OS), Duration of Response (DoR), Overall safety profile, Percentage of patients with liver metastases at baseline who have disease progression at D43 (phase II part 2)

Source: https://euclinicaltrials.eu/ctis-public/view/2024-515119-23-00